EU clinical trial 2024-520226-10-00: Evaluation of the efficacy of treatment with mucosal bacterial vaccines(autovaccines) versus suppressive antibiotic treatment in subjects with hip or knee prosthesis infections.
Protocol code: VACAB-2022
Sponsor: Instituto De Investigacion Marques De Valdecilla (Laboratory/Research/Testing facility). Phase: Therapeutic confirmatory (Phase III). Countries: Spain (authorised, recruiting).
Therapeutic area(s): Diseases [C] - Bacterial Infections and Mycoses [C01]
Gender: Female, Male. Age: 18-64 years, 65+ years. Enrolment: 20.
Status: Authorised, recruiting. Start date (EU): 2025-02-17. Decision date: 2025-01-23. Results received: No. Last updated: 2025-01-23.

Condition(s): Patients with hip or knee infections
Product: FLUCONAZOLE, SULFAMETHOXAZOLE AND TRIMETHOPRIM, AMOXICILLIN, METRONIDAZOLE, CIPROFLOXACIN, AMOXICILLIN AND BETA-LACTAMASE INHIBITOR, CLINDAMYCIN, DOXYCYCLINE, LINEZOLID, SODIUM CHLORIDE SOLUTION 0.9%

Primary endpoint: Clinical course: Presence of exudate, redness of the wound, pain, or other clinical signs of infection.
Endpoint(s): Safety assessment: local and systemic adverse events

Source: https://euclinicaltrials.eu/ctis-public/view/2024-520226-10-00